EU clinical trial 2024-512631-77-00: GIST-TEN: Randomized, prospective, multicentre, open label phase II study evaluating the interest of imatinib (Glivec) treatment maintenance or interruption after at least 10 years of treatment in patients with locally advanced/metastatic Gastrointestinal Stromal Tumors (GISTs)
Protocol code: ET21-084
Sponsor: Centre Leon Berard (Hospital/Clinic/Other health care facility). Phase: Therapeutic exploratory (Phase II). Countries: France (ongoing, recruiting).
Therapeutic area(s): Diseases [C] - Neoplasms [C04]
Gender: Female, Male. Age: 18-64 years, 65+ years. Enrolment: 50.
Status: Ongoing, recruiting. Start date (EU): 2021-12-20. Decision date: 2024-08-27. Results received: No. Last updated: 2026-07-02.

Condition(s): locally advanced or metastatic Gastrointestinal Stromal Tumors
Product: IMATINIB

Primary endpoint: The progression-free rate at 6 months (PFR-6m) expressed in each arm by the rate of patients with a non-progression disease 6 months after randomization.
Endpoint(s): PFS will be defined as the time from the date of randomization to the date of the first documented progression, or date of death due to any cause. Patients with no event at the time of the analysis will be censored at the date of last available tumor assessment., OS will be defined as the time from the date of randomization to the date of death due to any cause., The safety will be determined through the incidence of treatment emergent adverse events (TEAE), serious adverse Events (SAE) and death. Tolerance will be assessed using the NCI-CTC AE v5 grading scale., QoL will be assessed using the EORTC QLQ-C30 questionnaire., PFS rechallenge will be defined as the time from the date of imatinib reintroduction in the experimental arm to the date of subsequent progression, or date of death due to any cause. Patients with no event at the time of the analysis will be censored at the the date of last available tumor assessment., ORR after imatinib reintroduction will be defined as the proportion of patients with a best overall response of Partial Response (PR) or Complete Response (CR) after imatinib reintroduction, The duration of response to imatinib after reintroduction will be defined as the time from the date of first objective response following the reintroduction of imatinib to the date of the first subsequent documented radiological progression or death and censored at the date of last available tumor assessment.

Source: https://euclinicaltrials.eu/ctis-public/view/2024-512631-77-00